EU clinical trial 2024-516954-24-00: MRI of Neurometabolic Impairment in ALS and TIA Using Hyperpolarized Pyruvate
Sponsor: Aarhus Universitet (Educational Institution). Phase: Therapeutic exploratory (Phase II). Countries: Denmark (ongoing, recruiting).
Therapeutic area(s): Analytical, Diagnostic and Therapeutic Techniques and Equipment [E] - Investigative Techniques [E05]
Gender: Female, Male. Age: 18-64 years, 65+ years. Enrolment: 46.
Status: Ongoing, recruiting. Start date (EU): 2020-05-01. Decision date: 2024-09-12. Results received: No. Last updated: 2026-07-29.

Condition(s): TIA (Transient Ischemic Attack), ALS (Amyotrophic Lateral Sclerosis)
Product: Hyperpolarized [1-13C]pyruvate

Primary endpoint: Cerebral metabolism as assesed with 13C label exchange from hyperpolarized pyruvate to bicarbonate, lactate and alanine
Endpoint(s): Disease characterization from clinical exsamination, interviews and patient records.

Source: https://euclinicaltrials.eu/ctis-public/view/2024-516954-24-00